EU clinical trial 2024-512268-77-00: Cataract surgery and Inflammation – the role for preoperative NSAIDs (pre-CIN)
Sponsor: Oslo University Hospital HF (Hospital/Clinic/Other health care facility). Phase: Therapeutic use (Phase IV). Countries: Norway (ongoing, recruiting).
Therapeutic area(s): Diseases [C] - Eye Diseases [C11]
Gender: Female, Male. Age: 18-64 years, 65+ years. Enrolment: 120.
Status: Ongoing, recruiting. Start date (EU): 2024-10-02. Decision date: 2024-10-01. Results received: No. Last updated: 2024-10-01.

Condition(s): Cataract
Product: NEVANAC 3 mg/ml eye drops, suspension, Spersadex 1 mg/ml øyedråper, oppløsning

Primary endpoint: Laser flare

Source: https://euclinicaltrials.eu/ctis-public/view/2024-512268-77-00